EU clinical trial 2023-503388-40-00: A study of enfortumab vedotin given in the bladder for treatment of patients with non-muscle invasive bladder cancer (NMIBC).
Protocol code: SGN22E-004
Sponsor: Seagen Inc. (Pharmaceutical company). Phase: Human Pharmacology (Phase I)- Other. Countries: France (ended), Spain (ended), Germany (ended).
Therapeutic area(s): Diseases [C] - Neoplasms [C04]
Gender: Female, Male. Age: 18-64 years, 65+ years. Enrolment: 30.
Status: Ended. Start date (EU): 2021-08-24. End date (EU): 2025-09-22. End date: 2025-09-23. Decision date: 2023-10-25. Results received: No. Last updated: 2025-04-02.
Decision dates by country: FR: 2023-10-30, ES: 2023-10-25, DE: 2023-10-26

Condition(s): Non-muscle invasive bladder cancer

Source: https://euclinicaltrials.eu/ctis-public/view/2023-503388-40-00